EU clinical trial 2023-505974-14-00: A Multicenter, Single-arm, Open-label, Extension, Rollover Study To Evaluate The Long-term Safety And Efficacy Of Ocrelizumab In Patients With Multiple Sclerosis
Protocol code: MN43964
Sponsor: F. Hoffmann-La Roche AG (Pharmaceutical company). Phase: Therapeutic confirmatory (Phase III). Countries: Finland (ongoing, recruitment ended), Netherlands (ongoing, recruitment ended), Spain (ongoing, recruitment ended), Poland (ongoing, recruitment ended), Slovakia (ongoing, recruitment ended), Bulgaria (ongoing, recruitment ended), Sweden (ongoing, recruitment ended), Czechia (ongoing, recruitment ended), Belgium (ongoing, recruitment ended), Romania (ongoing, recruitment ended), Hungary (ongoing, recruitment ended), Italy (ongoing, recruitment ended), Croatia (ongoing, recruitment ended), Latvia (ongoing, recruitment ended), Germany (ongoing, recruitment ended), Lithuania (ongoing, recruitment ended), Estonia (ongoing, recruitment ended), France (ongoing, recruitment ended), Austria (ongoing, recruitment ended), Portugal (ongoing, recruitment ended).
Therapeutic area(s): Diseases [C] - Nervous System Diseases [C10]; Diseases [C] - Musculoskeletal Diseases [C05]
Gender: Female, Male. Age: 18-64 years. Enrolment: 809.
Status: Ongoing, recruitment ended. Start date (EU): 2022-06-23. Decision date: 2024-07-08. Results received: No. Last updated: 2026-06-11.
Decision dates by country: SK: 2024-07-08, LV: 2024-07-08, RO: 2024-07-11, BG: 2024-07-08, HR: 2024-07-09, SE: 2024-07-09, BE: 2024-07-10, FR: 2024-07-12, PT: 2024-07-10, EE: 2024-07-19, CZ: 2024-07-10, PL: 2024-07-15, LT: 2024-07-23, FI: 2024-07-08, HU: 2024-07-08, DE: 2024-07-12, NL: 2024-07-08, AT: 2024-07-15, IT: 2024-08-05, ES: 2024-07-11

Condition(s): Multiple Sclerosis (MS)
Product: Ocrevus 300 mg concentrate for solution for infusion

Primary endpoint: 1. Incidence and severity of adverse events, with severity determined according to the National Cancer Institute Common Terminology Criteria for Adverse Events version 5.0 (NCI CTCAE v5.0)
Endpoint(s): 1. Change in Expanded Disability Status Scale (EDSS) score over time, 2. Change in 9-Hole Peg Test (9HPT) and Timed 25-Foot Walk Test (T25FWT) over time, 3. The number of new, hypointense T1 lesions and number of new or enlarging T2 lesions, 4. The change in total volume of T2 lesions and in total T1 lesion volume

Source: https://euclinicaltrials.eu/ctis-public/view/2023-505974-14-00